EU clinical trial 2023-507559-30-00: A randomized, two-arm, placebo-controlled, participant and investigator-blinded study investigating the efficacy, safety and tolerability of DFV890 in patients with symptomatic knee osteoarthritis
Protocol code: CDFV890B12201
Sponsor: Novartis Pharma AG (Pharmaceutical company). Phase: Therapeutic exploratory (Phase II). Countries: Germany (ended), Spain (ended), Hungary (ended), Czechia (ended), Romania (ended).
Therapeutic area(s): Diseases [C] - Musculoskeletal Diseases [C05]
Gender: Female, Male. Age: 18-64 years, 65+ years. Enrolment: 76.
Status: Ended. Start date (EU): 2021-11-09. End date (EU): 2024-12-19. End date: 2024-12-23. Decision date: 2024-06-19. Results received: Yes. Last updated: 2024-12-16.
Decision dates by country: CZ: 2024-06-20, DE: 2024-06-21, HU: 2024-06-19, RO: 2024-06-26, ES: 2024-06-25

Condition(s): Knee Osteoarthritis
Product: Paracetamol/Codeine phosphate hemihydrate Accord 500 mg/30 mg tablets, PARACETAMOL, DFV890, Placebo to DFV890 10mg, Placebo to DFV890 25mg, DFV890

Primary endpoint: Change from baseline in Knee injury and Osteoarthritis Outcome Score (KOOS) pain sub-scale at week 12
Endpoint(s): Change from baseline in synovitis activity level measured from K-trans by DCE-MRI at week 12, Systemic and local Adverse Events and Serious Adverse Events, Electrocardiograms (ECGs) parameters, Vital signs, Hematology, blood chemistry and urinalysis., Change from baseline in serum high sensitivity C-reactive protein level and absolute neutrophil counts at week 2,4,8 and 12, Plasma samples to quantify concentrations of DFV890 at various time points (week 2 and week 12) and to derive PK parameters in plasma (including but not limited to Cmax, AUC last, AUC0-12h, and Cthrough), Change from baseline in KOOS sub-scales (other symptoms, function in daily living, function in sport and recreation, knee-related quality of life) at weeks 2, 4, 8 and 12, Change in KOOS pain subscale from baseline to weeks 2, 4, 8 and 12, Change in numeric rating scale (NRS) for pain from baseline to weeks 2, 4, 8 and 12

Source: https://euclinicaltrials.eu/ctis-public/view/2023-507559-30-00